EU clinical trial 2025-523307-29-00: ROSY-F: Roll-Over Study for Participants Who Have Completed a Previous Study with Benralizumab (Fasenra) and Are Judged by the Investigator to Clinically Benefit from Continued Treatment
Protocol code: D3250N00036
Sponsor: AstraZeneca AB (Pharmaceutical company). Phase: Therapeutic confirmatory (Phase III). Countries: Belgium (authorised, recruitment pending), Italy (authorised, recruitment pending), Netherlands (authorised, recruitment pending).
Therapeutic area(s): Diseases [C] - Respiratory Tract Diseases [C08]
Gender: Female, Male. Age: 0-17 years, 18-64 years, 65+ years. Enrolment: 15.
Status: Authorised, recruitment pending. Decision date: 2026-08-04. Results received: No. Last updated: 2026-08-06.
Decision dates by country: BE: 2026-08-04, IT: 2026-08-06, NL: 2026-08-04

Condition(s): Hypereosinophilic Syndrome (HES), Eosinophilic Granulomatosis with Polyangiitis (EGPA), Asthma
Product: Fasenra 30 mg solution for injection in pre-filled syringe, Benralizumab

Primary endpoint: Safety will be evaluated by monitoring and assessing SAEs and non-serious AEs reported throughout the study and until 8 weeks after the last dose of benralizumab.

Source: https://euclinicaltrials.eu/ctis-public/view/2025-523307-29-00